EU clinical trial 2023-508845-41-00: OPEN-LABEL, SINGLE-ARM TRIAL TO EVALUATE THE PHARMACOKINETICS AND SAFETY OF BIMEKIZUMAB IN PEDIATRIC STUDY PARTICIPANTS FROM 2 TO LESS THAN 18 YEARS OF AGE WITH ACTIVE JUVENILE IDIOPATHIC ARTHRITIS SUBTYPES ENTHESITIS-RELATED ARTHRITIS (INCLUDING JUVENILE-ONSET ANKYLOSING SPONDYLITIS) AND JUVENILE PSORIATIC ARTHRITIS
Protocol code: JA0005
Sponsor: UCB Biopharma (Pharmaceutical company). Phase: Therapeutic confirmatory (Phase III). Countries: France (ongoing, recruiting), Poland (ongoing, recruiting), Germany (ongoing, recruiting), Spain (ongoing, recruiting).
Therapeutic area(s): Diseases [C] - Musculoskeletal Diseases [C05]
Gender: Female, Male. Age: 0-17 years. Enrolment: 28.
Status: Ongoing, recruiting. Start date (EU): 2025-03-11. Decision date: 2024-10-14. Results received: No. Last updated: 2026-03-27.
Decision dates by country: FR: 2024-10-14, ES: 2024-10-14, DE: 2024-10-17, PL: 2024-10-21

Condition(s): Active juvenile idiopathic arthritis subtypes enthesitis-related arthritis (including juvenile-onset ankylosing spondylitis) and juvenile psoriatic arthritis
Product: bimekizumab

Primary endpoint: Plasma bimekizumab concentrations over the Initial Treatment Period
Endpoint(s): Occurrence of Treatment-emergent adverse events (TEAEs), Occurrence of Serious TEAEs, Occurrence of TEAEs leading to discontinuation of investigational medicinal product (IMP), Occurrence of TEAEs leading to withdrawal from the study, Occurrence of selected safety events of interest (including infection [serious, opportunistic, fungal, and tuberculosis (TB)], inflammatory bowel disease [IBD], and injection site reactions), Change from Baseline in vital signs (systolic blood pressure) at Week 16, Change from Baseline in vital signs (diastolic blood pressure) at Week 16, Change from Baseline in vital signs (heart rate) at Week 16, Change from Baseline in protocol planned laboratory analyses (chemistry) at Week 16, Change from Baseline in protocol planned laboratory analyses (hematology) at Week 16, Change from Baseline in growth assessments (height) at Week 16, Change from Baseline in growth assessments (weight) at Week 16, Acceptability assessments by injection site pain adverse events (AEs) during the Initial Treatment Period (Week 0 to Week 16), American College of Rheumatology pediatric (ACR Pedi) 30/50/70/90/100 response at Week 16, Change from Baseline in Juvenile Arthritis Disease Activity Score (JADAS27) -high sensitivity C-reactive protein (hs-CRP) at Week 16, Anti-bimekizumab antibody and neutralizing antibody detection prior to and following IMP administration during the Initial Treatment Period

Source: https://euclinicaltrials.eu/ctis-public/view/2023-508845-41-00